EU clinical trial 2025-522319-41-00: Non-inferiority study of TOCILIZUMAB in dose-banding versus dose-weight in rheumatoid arthritis with low activity or clinical remission
Protocol code: 24-AOI-MED-01
Sponsor: Centre Hospitalier Universitaire De Nice (Hospital/Clinic/Other health care facility). Phase: Therapeutic use (Phase IV). Countries: France (authorised, recruitment pending).
Therapeutic area(s): Diseases [C] - Musculoskeletal Diseases [C05]
Gender: Female, Male. Age: 18-64 years, 65+ years. Enrolment: 122.
Status: Authorised, recruitment pending. Decision date: 2026-03-24. Results received: No. Last updated: 2026-03-24.

Condition(s): rheumatoid arthritis
Product: RoActemra 20 mg/mL concentrate for solution for infusion, RoActemra 20 mg/mL concentrate for solution for infusion

Primary endpoint: The non-inferiority of TOCILIZUMAB in dose-banding will be evaluated through the study of the changes in the DAS28 activity score. The change in this activity score between M0 and M3 will be calculated:
Endpoint(s): The cost of preparing the bags is estimated based on the preparation time, corresponding to the sum of the sterilization, production, and bag release times over the 3 months of the study in each of the 2 groups. The total cost over the 3 months of the study will then be divided by the number of infusions to be administered in order to obtain a cost per infusion in each group., 2. The pharmaceutical release time will be defined as the time in minutes between medical approval, determined by the production of the prescription, and approval for transport to the department. ..., The non-reallocation rate will be defined by the number of unused bags over the number of reallocated bags.

Source: https://euclinicaltrials.eu/ctis-public/view/2025-522319-41-00